EU clinical trial 2024-517471-21-02: The GOAL study: GLP-1 receptor agonist treatment for Adolescents with Obesity secondary to Antipsychotic Medication - A feasibility study
Sponsor: Clinical Pharmacology, Department of (Health care). Phase: Therapeutic use (Phase IV). Countries: Denmark (ongoing, recruiting).
Therapeutic area(s): Psychiatry and Psychology [F] - Mental Disorders [F03]
Gender: Female, Male. Age: 0-17 years, 18-64 years. Enrolment: 34.
Status: Ongoing, recruiting. Start date (EU): 2025-06-24. Decision date: 2025-05-02. Results received: No. Last updated: 2026-02-27.

Condition(s): Adipositas
Product: Wegovy 0.5 mg FlexTouch solution for injection in pre-filled pen, Wegovy 1.7 mg FlexTouch solution for injection in pre-filled pen, Wegovy 2.4 mg FlexTouch solution for injection in pre-filled pen, Wegovy 0.25 mg FlexTouch solution for injection in pre-filled pen, Wegovy 1 mg FlexTouch solution for injection in pre-filled pen

Primary endpoint: Number of subjects completing the study from baseline to end-of-treatment
Endpoint(s): Body composition and bone mineral density evaluated by DXA., Blood pressure and heart rate., Changes in total body weight, hip and waist circumference., Beta cell function evaluated by homeostatic model assessment (HOMA)., Measures of psychopathology: Clinical Global Impressions Scale severity scale (CGI-S)., Antipsychotic medications, diet and exercise recorded in a diary together with alcohol, tobacco, recreational drug, and medication use., Change in blood sampling markers of Hepato-biliary biomarkers, Metabolic biomarkers, Inflammatory biomarkers, Lipid profile., 6-month follow-up assessing continuation of GLP-1-RA use on participant’s own initiative., MASLD evaluated by MRI proton density fat-fraction and biochemistry., Change in fat percentages using bioelectrical impedance analysis, Body-mass index standard deviation score (BMI-SDS)

Source: https://euclinicaltrials.eu/ctis-public/view/2024-517471-21-02